EU clinical trial 2022-502776-22-00: Improved Recovery by Iron following Surgery with blood loss, a double-blind multi-centre randomized controlled phase III drug trial (the IRIS-trial)
Sponsor: Region Uppsala (Hospital/Clinic/Other health care facility). Phase: Therapeutic confirmatory (Phase III). Countries: Sweden (ongoing, recruiting).
Therapeutic area(s): Diseases [C] - Cardiovascular Diseases [C14]; Diseases [C] - Hemic and Lymphatic Diseases [C15]; Diseases [C] - Neoplasms [C04]
Gender: Female, Male. Age: 18-64 years, 65+ years. Enrolment: 338.
Status: Ongoing, recruiting. Start date (EU): 2024-09-05. Decision date: 2024-03-13. Results received: No. Last updated: 2024-03-13.

Condition(s): Anemia
Product: ELECTROLYTES

Primary endpoint: To examine if 1000 mg iv Ferric Carboxymaltose administered immediately following hepatic or pancreatic resection or complex aortic surgery with 400 – 4000 ml perioperative blood loss affect a composite of death, number of red blood cells transfusions, post-operative severe anaemia (Hb < 80 g/L) and change in FACT-An QoL compared to pre-operative baseline at five weeks after surgery. The composite endpoint is assessed by win ratio in the order given above.
Endpoint(s): If the intervention affects levels of post operative Hb, and if this is linked to the primary outcome and affects early post operative recovery and performance status five weeks after surgery., If the intervention affects complication rate after surgery, re-admissions to hospital after discharge and re-interventions after primary surgery. Analysed 1 year after surgery., If the intervention affects chance of receiving systemic oncological therapy in case of malignant disease. Follow-up 1 year after surgery., If the intervention affects rate of spinal ischemia after complex aortic repair. Follow-up 1 year after surgery., Effects of Ferric Carboxymaltose between 5 weeks to 5 years after surgery in different subgroups., Number of adverse events reported during administration of Ferric Carboxymaltose iv and during the 5-week follow-up after surgery., Morbidity, mortality and recurrence of oncological disease reported during the 5-year follow-up.

Source: https://euclinicaltrials.eu/ctis-public/view/2022-502776-22-00